EU clinical trial 2023-508635-31-00: CA209-9DW - A Randomized, Multi-center, Phase 3 Study of Nivolumab in Combination with Ipilimumab Compared to Sorafenib or Lenvatinib as First-Line Treatment in Participants with Advanced Hepatocellular Carcinoma
Protocol code: CA209-9DW
Sponsor: Bristol-Myers Squibb Services Unlimited Company (Pharmaceutical company). Phase: Therapeutic confirmatory (Phase III). Countries: Belgium (ongoing, recruitment ended), Poland (ongoing, recruitment ended), France (ongoing, recruitment ended), Spain (ongoing, recruitment ended), Romania (ongoing, recruitment ended), Italy (ongoing, recruitment ended), Germany (ongoing, recruitment ended), Austria (ongoing, recruitment ended).
Therapeutic area(s): Diseases [C] - Neoplasms [C04]
Gender: Female, Male. Age: 18-64 years, 65+ years. Enrolment: 373.
Status: Ongoing, recruitment ended. Start date (EU): 2019-12-03. Decision date: 2024-02-27. Results received: No. Last updated: 2026-08-08.
Decision dates by country: AT: 2024-04-08, RO: 2024-03-05, BE: 2024-03-12, IT: 2024-03-01, PL: 2024-03-12, ES: 2024-02-27, DE: 2024-02-28, FR: 2024-03-04

Condition(s): Hepatocellular Carcinoma, Hepatocellular Carcinoma, Hepatocellular Carcinoma, Hepatocellular Carcinoma
Product: Sorafenib 200mg Film-Coated Tablets, YERVOY 5 mg/ml concentrate for solution for infusion, OPDIVO 10 mg/mL concentrate for solution for infusion., LENVATINIB

Primary endpoint: OS, defined as the time between the date of randomization and the date of death (by any cause).
Endpoint(s): ORR, defined as the percentage of participants whose BOR is either a confirmed CR or PR., DOR, defined as the time from the first documented evidence of a response of CR or PR until the first documented disease progression or death due to any cause, whichever occurs first, TTSD, defined as the time from randomization until a clinically meaningful decline in the HCS subscale score of the FACT-Hep., PFS, defined as the time from randomization to the first documented disease progression or death due to any cause, whichever occurs first., TTP, defined as the time from randomization to the first documented disease progression.

Source: https://euclinicaltrials.eu/ctis-public/view/2023-508635-31-00